EU clinical trial 2023-506354-20-00: A study to evaluate the Safety, Tolerability, Pharmacokinetics (PK), Pharmacodynamics (PD), and preliminary Anti-Tumor activity of RO7616789 in participants with Advanced Small Cell Lung Cancer and other Neuroendocrine Carcinomas
Protocol code: BP44382
Sponsor: F. Hoffmann-La Roche AG (Pharmaceutical company). Phase: Human Pharmacology (Phase I)- First administration to humans. Countries: Denmark (ended), Poland (ended), Spain (ended), Germany (ended), France (ended).
Therapeutic area(s): Diseases [C] - Neoplasms [C04]
Gender: Female, Male. Age: 18-64 years, 65+ years. Enrolment: 36.
Status: Ended. Start date (EU): 2024-02-20. End date (EU): 2025-03-04. End date: 2025-03-05. Decision date: 2023-11-30. Results received: No. Last updated: 2024-07-22.
Decision dates by country: DK: 2023-11-27, DE: 2023-11-30, ES: 2023-12-01, FR: 2024-02-01, PL: 2023-11-30

Condition(s): Small Cell Lung Cancer and Neuroendocrine Carcinoma

Source: https://euclinicaltrials.eu/ctis-public/view/2023-506354-20-00